EU clinical trial 2024-518293-13-01: Ventilation/Perfusion PET/CT with Galligas and 68Ga-MAA for regional lung function assessment after pulmonary embolism
Sponsor: Centre Hospitalier Regional Et Universitaire De Brest (Hospital/Clinic/Other health care facility). Phase: Phase I and Phase II (Integrated)- Other. Countries: France (authorised, recruitment pending).
Therapeutic area(s): Analytical, Diagnostic and Therapeutic Techniques and Equipment [E] - Investigative Techniques [E05]
Gender: Female, Male. Age: 18-64 years, 65+ years. Enrolment: 32.
Status: Authorised, recruitment pending. Decision date: 2025-01-28. Results received: No. Last updated: 2026-07-10.

Condition(s): Pulmonary embolism
Product: PULMOTEC, Creuset de graphite pour la préparation de Technegas pour inhalation, Pulmocis 2 mg trousse pour préparation radiopharmaceutique

Primary endpoint: Pulmonary vascular obstruction index (PVOI), expressed as a percentage of whole lung volume, on V/Q PET/CT imaging.
Endpoint(s): V/Q PET/CT regional lung functional volumes : - pulmonary vascular obstruction index, V/Q PET/CT regional lung functional volumes : - pulmonary ventilation impairment index, Global lung function parameters - Dyspnea scores : MDP, Borg and MMRC, Global lung function parameters - Respiratory functional tests (FVC, FEV, FVC-FEV) and TLco, Global lung function parameters - Cardio Pulmonary Exercise Tes, Global lung function parameters - Cycloergometer endurance tes, Global lung function parameters - 6MWT, Quality of life - PEmb-QoL score

Source: https://euclinicaltrials.eu/ctis-public/view/2024-518293-13-01